EU clinical trial 2025-520888-41-00: PROlonged versus Single dose in PEnicillin oral Challenge Testing double-blind parallel randomized placebo cOntrolled tRial – PROSPECTOR-2 Study
Sponsor: Gentofte Hospital, Austin Health (Hospital/Clinic/Other health care facility). Phase: Therapeutic use (Phase IV). Countries: Belgium (authorised, recruitment pending), Denmark (ongoing, recruiting).
Therapeutic area(s): Diseases [C] - Immune System Diseases [C20]
Gender: Female, Male. Age: 18-64 years, 65+ years. Enrolment: 160.
Start date (EU): 2025-12-10. Decision date: 2025-10-28. Results received: No. Last updated: 2026-05-26.
Decision dates by country: DK: 2025-10-28, BE: 2025-10-28

Condition(s): Penicillin allergy
Product: Amoxicillin, Capsugel Belgium N.V Empty hard gelatin capsules size AA Elong, DB-caps Part number G7ECL000020 see IMPD

Primary endpoint: Positive oral challenge (i.e. immune mediated reaction up to and including day 7 following the first test dose, number and percentage of participants), as adjudged by independent blinded panel
Endpoint(s): Positive oral challenge (i.e. immune mediated reaction up to and including day 14 following the first test dose, number and percentage of participants), as adjudged by independent blinded panel, Non-inferiority of single dose challenge to prolonged challenge (risk difference with two-sided 95% confidence interval using 10% as clinically relevant non-inferiority margin), Time to positive oral challenge, Quality of life (measured by Drug Hypersensitivity Quality of Life Questionnaire (DrHy-Q) at day 0 and 90

Source: https://euclinicaltrials.eu/ctis-public/view/2025-520888-41-00